EU clinical trial 2024-519418-29-00: NBI-1065845-MDD3024: A Randomized, Double-Blind, Placebo-Controlled Study to Assess the Efficacy and Safety of NBI-1065845 as Adjunctive Treatment in Subjects with Major Depressive Disorder (MDD)
Protocol code: NBI-1065845-MDD3024
Sponsor: Neurocrine Biosciences Inc. (Pharmaceutical company). Phase: Therapeutic confirmatory (Phase III). Countries: Poland (ongoing, recruiting), Croatia (ongoing, recruiting), Czechia (ongoing, recruiting).
Therapeutic area(s): Psychiatry and Psychology [F] - Mental Disorders [F03]
Gender: Female, Male. Age: 18-64 years, 65+ years. Enrolment: 82.
Status: Ongoing, recruiting. Start date (EU): 2025-09-19. Decision date: 2025-06-18. Results received: No. Last updated: 2026-05-11.
Decision dates by country: CZ: 2025-06-18, HR: 2025-06-23, PL: 2025-06-23

Condition(s): Major Depressive Disorder
Product: Identical to NBI-1065845 tablets without active drug, NBI-1065845

Primary endpoint: The primary endpoint for this study will be the change from baseline in total MADRS score at Day 56.
Endpoint(s): Change from baseline in SDS total score at Day 56, Change from baseline in CGI-S score at Day 56

Source: https://euclinicaltrials.eu/ctis-public/view/2024-519418-29-00